EU clinical trial 2023-508880-61-00: A six-way relative bioavailability study comparing 10, 30, 40 and 50 mg leniolisib film coated tablets and 30 mg film coated granules with 70 mg film coated tablet in healthy volunteers
Protocol code: LE 1102
Sponsor: Pharming Technologies B.V. (Pharmaceutical company). Phase: Human Pharmacology (Phase I)- Other. Countries: Germany (ended).
Therapeutic area(s): Diseases [C] - Immune System Diseases [C20]
Gender: Female, Male. Age: 18-64 years. Enrolment: 18.
Status: Ended. Start date (EU): 2024-03-06. End date (EU): 2024-05-26. Decision date: 2024-02-28. Results received: Yes. Last updated: 2024-02-28.

Condition(s): Activated Phosphoinositide 3-Kinase Delta Syndrome
Product: CDZ173/Leniolisib, CDZ173/Leniolisib, CDZ173/Leniolisib, CDZ173/Leniolisib, CDZ173/Leniolisib, CDZ173/Leniolisib

Primary endpoint: The ratio of geometric least square means between the five test formulations and the reference formulation for: • Dose normalized maximum observed drug concentration (Cmax); • Dose normalised area under the concentration versus time curve (AUC) from time zero to the last time point with a measurable concentration (AUC0-tlast); • Dose normalised AUC from time zero to infinity (AUC0-∞)
Endpoint(s): Incidence of treatment-emergent adverse events (TEAEs) comparison between the five test formulations and the reference formulation.

Source: https://euclinicaltrials.eu/ctis-public/view/2023-508880-61-00